EU clinical trial 2022-500254-41-00: A Phase III, Randomized, Open-label Study to Evaluate Pembrolizumab as Neoadjuvant Therapy and in Combination With Standard of Care as Adjuvant Therapy for Stage III-IVA Resectable Locoregionally Advanced Head and Neck Squamous Cell Carcinoma (LA HNSCC)
Protocol code: MK-3475-689
Sponsor: Merck Sharp & Dohme LLC (Pharmaceutical company). Phase: Therapeutic confirmatory (Phase III). Countries: Ireland (ongoing, recruitment ended), Portugal (ongoing, recruitment ended), Germany (ongoing, recruitment ended), Belgium (ongoing, recruitment ended), Hungary (ongoing, recruitment ended), Austria (ongoing, recruitment ended), Poland (ongoing, recruitment ended), France (ongoing, recruitment ended), Spain (ongoing, recruitment ended).
Therapeutic area(s): Diseases [C] - Neoplasms [C04]
Gender: Female, Male. Age: 18-64 years, 65+ years. Enrolment: 218.
Status: Ongoing, recruitment ended. Start date (EU): 2018-12-13. Decision date: 2022-12-02. Results received: No. Last updated: 2026-07-20.
Decision dates by country: IE: 2022-12-05, PT: 2022-12-02, BE: 2023-01-12, HU: 2022-12-06, ES: 2023-01-23, AT: 2022-12-12, FR: 2023-01-16, DE: 2022-12-28, PL: 2023-01-23

Condition(s): Stage III-IVA Resectable Locoregionally Advanced Head and Neck Squamous Cell Carcinoma (LA HNSCC)
Product: KEYTRUDA 25 mg/mL concentrate for solution for infusion, CISPLATIN

Primary endpoint: Event-free Survival (EFS)
Endpoint(s): Major Pathological Response (mPR), Overall Survival (OS), Pathological Complete Response (pCR), Change From Baseline in Global Health Status/Quality of Life Scale (GHS/QoL), Change From Baseline in Global Health Status/Physical Functioning Scales, Change from Baseline in Swallowing, Speech, and Pain Symptoms, Percentage of Participants Experiencing an Adverse Event (AEs), Percentage of Participants Discontinuing Study Drug Due to AEs

Source: https://euclinicaltrials.eu/ctis-public/view/2022-500254-41-00